EU clinical trial 2024-511072-33-00: Short-term combined acalabrutinib and venetoclax treatment of newly diagnosed patients with CLL at high risk of infection and/or early treatment, who do not fulfil IWCLL treatment criteria for treatment. A randomized study with extensive immune phenotyping.
Protocol code: PreVent-ACaLL
Sponsor: Rigshospitalet (Hospital/Clinic/Other health care facility). Phase: Therapeutic exploratory (Phase II). Countries: Denmark (ongoing, recruitment ended), Netherlands (ongoing, recruitment ended), Sweden (ongoing, recruitment ended).
Therapeutic area(s): Diseases [C] - Neoplasms [C04]
Gender: Female, Male. Age: 18-64 years, 65+ years. Enrolment: 50.
Status: Ongoing, recruitment ended. Start date (EU): 2024-06-12. Decision date: 2024-06-12. Results received: No. Last updated: 2025-03-17.
Decision dates by country: DK: 2024-06-12, SE: 2024-06-13, NL: 2024-06-14

Condition(s): Chronic Lymphocytic Leukemia
Product: Venclyxto 10 mg film-coated tablets, Calquence 100 mg hard capsules, Venclyxto 100 mg film-coated tablets, Venclyxto 50 mg film-coated tablets

Primary endpoint: Grade ≥3-Infection-free survival in the treatment arm compared to the observation arm 12 weeks after finishing treatment (24 weeks after treatment initiation). This is a non-inferiority analysis as detailed in statistical analysis plan to assure safety of the combination treatment in this preemptive trial population.
Endpoint(s): Grade ≥3-infection free, CLL-treatment-free survival at end of treatment, 1 year and 2 years after enrollment, Overall survival and cause of death, Treatment free survival, Rate and CTCAE grade of infections, Response rate and duration according to IWCLL criteria, Treatment related adverse events, type, frequency and severity during and for 2 years after treatment, Immune function as assessed by immune phenotyping, functional TruCulture assays and measurements of cytokine levels

Source: https://euclinicaltrials.eu/ctis-public/view/2024-511072-33-00